EU clinical trial 2023-505120-59-00: A Phase 3 Multicenter, Randomized, Double-blind, Placebo-controlled Study to Evaluate the Efficacy and Safety of JNJ-77242113 for the Treatment of Participants with Moderate to Severe Plaque Psoriasis with Randomized Withdrawal and Retreatment
Protocol code: 77242113PSO3001
Sponsor: Janssen - Cilag International (Pharmaceutical company). Phase: Therapeutic confirmatory (Phase III). Countries: Germany (ongoing, recruitment ended), Hungary (ongoing, recruitment ended), Italy (ongoing, recruitment ended), Spain (ongoing, recruitment ended), Poland (ongoing, recruitment ended), France (ended).
Therapeutic area(s): Diseases [C] - Immune System Diseases [C20]
Gender: Female, Male. Age: 0-17 years, 18-64 years, 65+ years. Enrolment: 281.
Start date (EU): 2023-12-19. Decision date: 2023-12-19. Results received: No. Last updated: 2026-04-27.
Decision dates by country: IT: 2024-01-08, FR: 2024-01-03, ES: 2023-12-22, PL: 2023-12-21, DE: 2023-12-19, HU: 2023-12-20

Condition(s): Moderate to Severe Plaque Psoriasis
Product: JNJ-77242113, Film-Coated Tablet without JNJ-77242113

Primary endpoint: IGA score of 0 or 1 and a ≥2-grade improvement from baseline at Week 16., PASI 90 at Week 16.

Source: https://euclinicaltrials.eu/ctis-public/view/2023-505120-59-00